EU clinical trial 2024-513165-39-00: A Phase 3 Randomized, Open-label Clinical Study to Evaluate the Pharmacokinetics and Safety of Subcutaneous Pembrolizumab Coformulated With Hyaluronidase (MK-3475A) Versus Intravenous Pembrolizumab, in the First-line Treatment of Participants With Metastatic Non-small Cell Lung Cancer With PD-L1 TPS 50% or Greater
Protocol code: MK-3475A-F84
Sponsor: Merck Sharp & Dohme LLC (Pharmaceutical company). Phase: Therapeutic confirmatory (Phase III). Countries: Romania (ongoing, recruitment ended), Spain (ended), Germany (ongoing, recruitment ended), Poland (ongoing, recruitment ended).
Therapeutic area(s): Diseases [C] - Neoplasms [C04]
Gender: Female, Male. Age: 18-64 years, 65+ years. Enrolment: 46.
Start date (EU): 2024-11-11. Decision date: 2024-10-21. Results received: No. Last updated: 2026-05-22.
Decision dates by country: PL: 2024-10-28, ES: 2024-10-21, RO: 2024-10-25, DE: 2025-07-03

Condition(s): Participants With Metastatic Non-small Cell Lung Cancer With PD-L1 TPS ≥50%
Product: KEYTRUDA 25 mg/mL concentrate for solution for infusion, MK-3475A

Primary endpoint: Area Under the Curve (AUC) of Pembrolizumab Measured After the First Dose, Trough Concentration (Ctrough) of Pembrolizumab Measured at Steady State
Endpoint(s): Number of Participants Who Report ≥1 Adverse Event (AE), Number of Participants Who Discontinue Study Intervention Due to an AE

Source: https://euclinicaltrials.eu/ctis-public/view/2024-513165-39-00